EU clinical trial 2024-518971-76-00: With Ponatinib on the track for treatment-free-remission in chronic myeloid leukemia
Protocol code: Pontrack01
Sponsor: Heidelberg University (Educational Institution). Phase: Therapeutic exploratory (Phase II). Countries: Germany (ended).
Therapeutic area(s): Diseases [C] - Neoplasms [C04]; Not possible to specify; Diseases [C] - Hemic and Lymphatic Diseases [C15]
Gender: Female, Male. Age: 18-64 years, 65+ years. Enrolment: 17.
Status: Ended. Start date (EU): 2024-12-21. End date (EU): 2026-02-05. Decision date: 2024-11-22. Results received: No. Last updated: 2024-11-22.

Condition(s): chronic myeloid leukemia in chronic phase
Product: Iclusig 15 mg film-coated tablets

Primary endpoint: MR4 after 24 months of ponatinib treatment
Endpoint(s): Molecular status (no MMR, MMR, MR4, and MR4.5) at the evaluation times defined in the visit schedule, Time from inclusion to first MR4 and to first MR4.5, Safety profile, tolerability and adverse events under ponatinib treatment, Health-related quality of life (QoL) under ponatinib treatment, Identification of clinical and biological factors associated with the achievement of MR4 or better under ponatinib (e.g. risk scores (Sokal/Euro/EUTOS/ ELTS), gender, duration of TKI treatment, molecular level at study entry, Evaluation of medico-economic impact of ponatinib therapy with the possibility of a TFR approach, Evaluation of overall survival and progression-free survival

Source: https://euclinicaltrials.eu/ctis-public/view/2024-518971-76-00